EU clinical trial 2023-504898-20-00: A multicenter, open label, two cohort, single arm, phase II study to evaluate the efficacy and safety of the anti-TROP-2 antibody-drug conjugate sacituzumab govitecan in patients with advanced differentiated and anaplastic thyroid neoplasms.
Protocol code: GETNE-T2318
Sponsor: Grupo Espanol De Tumores Neuroendocrinos (Patient organisation/association). Phase: Therapeutic exploratory (Phase II). Countries: Spain (ongoing, recruiting).
Therapeutic area(s): Diseases [C] - Neoplasms [C04]; Diseases [C] - Hormonal diseases [C19]
Gender: Female, Male. Age: 18-64 years, 65+ years. Enrolment: 42.
Status: Ongoing, recruiting. Start date (EU): 2024-07-30. Decision date: 2024-02-05. Results received: No. Last updated: 2026-03-17.

Condition(s): Thyroid neoplasms: ● Cohort 1: Advanced radioactive-iodine refractory Differentiated Thyroid Carcinoma (DTC) ● Cohort 2: Advanced Anaplastic Thyroid Carcinoma (ATC).
Product: Trodelvy 200 mg powder for concentrate for solution for infusion

Primary endpoint: The primary endpoint will be objective response rate (ORR), defined as the percentage/proportion of patients with confirmed complete response (CR) or partial response (PR) as their overall best response throughout the study period. Objective responses will be assessed locally by the investigator according to RECIST, version 1.1 (Appendix 3), and indicating the change in size of tumors as compared with baseline, at the first dose of study treatment.
Endpoint(s): Efficacy secondary endpoints will be analyzed per cohort: ● Disease control rate (DCR). ● Duration of the response (DoR). ● Progression free survival (PFS). ● Overall survival (OS). ● Efficacy variables will be reported for subgroups to find potential correlation between patient characteristics (i.e. age, gender, ECOG, AJCC stage, differentiation, or previous treatments) and the clinical outcomes to sacituzumab govitecan., Secondary safety endpoints: ● Frequency and severity of adverse events and Treatment-related adverse events (TRAEs) assessed by NCI CTCAE v5.0. ● Frequency of AEs leading to treatment discontinuation. ● Health-related quality of life (HRQoL), assessed through the European Organization for Research and Treatment of Cancer Quality of Life Questionnaire C30 (EORTC QLQ-C30) version 3., Secondary exploratory endpoints: ● Correlation of TROP-2 expression levels with efficacy endpoints (i.e. ORR, PFS, OS). ● Correlation of tumor genetic alterations with efficacy endpoints (i.e. ORR, PFS, OS).

Source: https://euclinicaltrials.eu/ctis-public/view/2023-504898-20-00